EU clinical trial 2025-522259-24-00: Bioequivalence of Lenvatinib 10 mg Capsules in Healthy Participants Under Fasting Conditions
Protocol code: BLCL-LEN-FDA-03
Sponsor: Bluepharma Industria Farmaceutica S.A. (Pharmaceutical company). Phase: Human Pharmacology (Phase I)- Bioequivalence Study. Countries: Portugal (ended).
Therapeutic area(s): Not possible to specify
Gender: Female, Male. Age: 18-64 years. Enrolment: 54.
Status: Ended. Start date (EU): 2025-10-06. End date (EU): 2025-11-24. Decision date: 2025-07-07. Results received: No. Last updated: 2025-10-24.

Condition(s): No medical condition

Source: https://euclinicaltrials.eu/ctis-public/view/2025-522259-24-00